EU clinical trial 2023-510392-66-00: A Long-term Follow-up Study of Patients with MPS IIIA from Gene Therapy Clinical Trials Involving the Administration of ABO-102 (scAAV9.U1a.hSGSH)
Protocol code: LTFU-ABO-102
Sponsor: Ultragenyx Pharmaceutical Inc. (Pharmaceutical company). Phase: Therapeutic confirmatory (Phase III). Countries: Spain (ongoing, recruiting).
Therapeutic area(s): Diseases [C] - Congenital, Hereditary, and Neonatal Diseases and Abnormalities [C16]
Gender: Female, Male. Age: 0-17 years. Enrolment: 24.
Status: Ongoing, recruiting. Start date (EU): 2020-11-23. Decision date: 2024-02-07. Results received: No. Last updated: 2025-10-20.

Condition(s): Mucopolysaccharidosis type IIIA
Product: ABO-102, ABO-102, ABO-102

Primary endpoint: Safety: Incidence of treatment-emergent adverse events (TEAEs) and treatment-emergent serious adverse events (SAEs), Efficacy: Bayley Scales of Infant and Toddler Development - Third Edition (BSITD-III) Cognitive raw score
Endpoint(s): Cerebrospinal fluid (CSF) heparan sulfate (HS) (disaccharide) exposure, CSF HS percentage change from baseline in prior trial, BSITD-III Receptive Communication raw score, BSITD-III Expressive Communication raw score, Total cortical volume (cm 3) annualized percentage change from baseline in prior trial, Survival

Source: https://euclinicaltrials.eu/ctis-public/view/2023-510392-66-00